EU clinical trial 2024-517757-27-00: A phase 4 open-label study to evaluate the safety after switching to CSL312 (Garadacimab) from current prophylactic HAE treatment in subjects with HAE ≥ 12 years of age
Protocol code: CSL312_4002
Sponsor: CSL Behring LLC (Pharmaceutical company). Phase: Therapeutic use (Phase IV). Countries: Germany (ended).
Therapeutic area(s): Diseases [C] - Congenital, Hereditary, and Neonatal Diseases and Abnormalities [C16]
Gender: Female, Male. Age: 0-17 years, 18-64 years, 65+ years. Enrolment: 5.
Status: Ended. Start date (EU): 2026-01-29. End date (EU): 2026-05-28. End date: 2026-06-29. Decision date: 2025-08-15. Results received: No. Last updated: 2025-10-06.
Decision dates by country: DE: 2025-10-06

Condition(s): Hereditary Angioedema (HAE)
Product: garadacimab

Primary endpoint: 1. Number of Participants with Treatment Emergent Adverse Events (TEAEs), 2. Percentage of Participants with TEAEs, 3. Number of TEAEs, 4. Rate of TEAEs per injection, 5. Rate of TEAEs per participant year
Endpoint(s): 1. Number of Participants With: Serious Adverse Events (SAEs), Deaths, Related TEAEs, TEAEs leading to study discontinuation, TEAEs by severity, Laboratory Findings Reported as an AE, and Adverse Events of Special Interest (AESI), 2. Percentage of Participants With: SAEs, Deaths, Treatment Related TEAEs, TEAEs leading to study discontinuation, TEAEs by severity, Laboratory Findings Reported as an AE, and AESI, 3. Number of SAEs, Deaths, Treatment Related TEAEs, TEAEs leading to study discontinuation, TEAEs by severity, AESI and Laboratory Findings Reported as an AE, and AESI, 4. Rate per injection of: SAEs, Deaths, Treatment Related TEAEs, TEAEs leading to study discontinuation, TEAEs by severity, Laboratory Findings Reported as an AE, and AESI, 5. Rate per participant year of: SAEs, Deaths, Treatment Related TEAEs, TEAEs leading to study discontinuation, TEAEs by severity, Laboratory Findings Reported as an AE, and AESI, 6. Number of Participants with Anti-garadacimab Antibodies, 7. Percentage of Participants with Anti-garadacimab Antibodies, 8. Plasma Concentrations of Garadacimab, 9. Percentage of Participants who Indicated Their Preference for Garadacimab

Source: https://euclinicaltrials.eu/ctis-public/view/2024-517757-27-00